EU clinical trial 2023-505625-14-00: A Multicenter, Open-Label, Phase I/II Study to Evaluate the Safety, Efficacy, Tolerability and Pharmacokinetics of Escalating Doses of Glofitamab (RO7082859) as a Single Agent and in Combination with Obinutuzumab Administered After a Fixed, Single Dose Pre-Treatment of Obinutuzumab (Gazyva®/Gazyvaro™) in Patients with Relapsed/Refractory B-Cell Non-Hodgkin’s Lymphoma
Protocol code: NP30179
Sponsor: F. Hoffmann-La Roche AG (Pharmaceutical company). Phase: Phase I and Phase II (Integrated)- First administration to humans. Countries: Belgium (ongoing, recruitment ended), Italy (ongoing, recruitment ended), Czechia (ongoing, recruitment ended), Denmark (ongoing, recruitment ended), France (ongoing, recruitment ended), Poland (ongoing, recruitment ended), Finland (ongoing, recruitment ended), Spain (ongoing, recruitment ended).
Therapeutic area(s): Diseases [C] - Neoplasms [C04]; Psychiatry and Psychology [F] - Behavioral Disciplines and Activities [F04]
Gender: Female, Male. Age: 18-64 years, 65+ years. Enrolment: 459.
Status: Ongoing, recruitment ended. Start date (EU): 2017-01-31. Decision date: 2024-08-01. Results received: No. Last updated: 2026-07-16.
Decision dates by country: BE: 2024-08-02, PL: 2024-08-04, DK: 2024-08-06, FI: 2024-08-02, ES: 2024-08-01, FR: 2024-08-02, CZ: 2024-08-01, IT: 2024-08-07

Condition(s): Relapsed/refractory B-cell non-Hodgkin’s lymphoma (r/r NHL)
Product: Columvi 10 mg concentrate for solution for infusion, Gazyvaro 1,000 mg concentrate for solution for infusion., Glofitamab, RoActemra 20 mg/mL concentrate for solution for infusion

Primary endpoint: 1. Incidence of dose-limiting toxicity (DLTs), 2. The primary safety endpoints will be incidence of all adverse events, changes in vital signs, clinical laboratory values, electrocardiograms and incidence of DLTs, 3. Incidence, nature, and severity of all adverse events, 4. Incidence of cytokine-release related events (cytokine-release syndrome [CRS] and infusion-related reactions [IRRs]) according to the grading criteria in Lee (2014), 5. Changes in clinical laboratory values: hematology and biochemistry test results, 6. Changes in vital signs, including systolic and diastolic blood pressure, respiratory rate, pulse rate, and body temperature, 7. Incidence of ECG abnormality, 8. Total exposure (area under the concentration-time curve [AUC]) of glofitamab, 9. Maximum serum concentration (Cmax) of glofitamab, 10. Minimum serum concentration (Cmin) of glofitamab, 11. Clearance (CL) of glofitamab, 12. Volume of distribution (Vz) of glofitamab, 13. Independent Review Committee (IRC)-assessed CR rate using Lugano criteria
Endpoint(s): 1. Investigator (INV)-assessed CR rate (Lugano classification), 2. IRC-assessed overall response rate (ORR) (Lugano classification), 3. INV-assessed ORR (Lugano classification), 4. IRC - and INV-assessed duration of complete response (Lugano Classification), 5. IRC- and INV-assessed duration of response (Lugano classification), 6. IRC-assessed progression-free survival (PFS) and INV-assessed PFS (Lugano classification), 7. IRC-assessed time to first complete response (TFCR) (Lugano classification), 8. INV-assessed TFCR (Lugano classification), 9. IRC-assessed time to first overall response (TFOR) (Lugano classification), 10. INV-assessed TFOR (Lugano classification), 11. Overall survival, 12. Change from baseline in physical function, role function, and health-related quality of life European organization for research and treatment of cancer quality of Life questionnaire core 30 based on European organization for research and treatment of cancer quality of Life questionnaire core 30, 13. Change from baseline in disease-related symptoms based on the functional assessment of cancer therapy-lymphoma scale, 14. Incidence of ADA formation and events related to immune complex deposition and activation

Source: https://euclinicaltrials.eu/ctis-public/view/2023-505625-14-00